EU clinical trial 2023-508870-27-00: A randomized, Phase 2, open label study evaluating subcutaneous administration of isatuximab in combination with carfilzomib and dexamethasone in adult participants with relapsed and/or refractory multiple myeloma (RRMM)
Protocol code: ACT17453
Sponsor: Sanofi-Aventis Recherche & Developpement (Pharmaceutical company). Phase: Therapeutic exploratory (Phase II). Countries: Greece (ongoing, recruitment ended), Czechia (ongoing, recruitment ended), Portugal (ongoing, recruitment ended).
Therapeutic area(s): Diseases [C] - Neoplasms [C04]
Gender: Female, Male. Age: 18-64 years, 65+ years. Enrolment: 55.
Status: Ongoing, recruitment ended. Start date (EU): 2023-01-04. Decision date: 2024-04-30. Results received: No. Last updated: 2026-05-15.
Decision dates by country: GR: 2024-06-07, PT: 2024-04-30, CZ: 2024-05-02

Condition(s): Cancer - Relapsed/refractory multiple myeloma
Product: Isatuximab, Kyprolis 60 mg powder for solution for infusion, METHYLPREDNISOLONE, MONTELUKAST, DexaGalen® 8 mg injekt Injektionslösung, DIPHENHYDRAMINE, Dexamethason 4 mg JENAPHARM®, Dr. Reddy's Carfilzomib, PARACETAMOL

Primary endpoint: Overall response rate (ORR) – Cohorts 1 to 3, Maximum observed concentration (Cmax) over Cycle 1- Cohorts 4 to 5, Cumulative area under the curve over the first 4 weeks (AUC4weeks) of isatuximab treatment- Cohorts 4 to 5
Endpoint(s): Proportion of participants preferring OBDS over manual administration of isatuximab SC at Day 15 of Cycle 6, Incidence rate of infusion reactions (IRs), Number of participants with treatment-emergent adverse events (TEAEs), serious adverse events (SAEs), and changes in laboratory parameters, Incidence rate of injection site reactions (ISRs), PK concentration: trough plasma concentration (Ctrough), Overall response rate (ORR), Duration of response (DOR), Time to first response (TT1R), Time to best response (TTBR), Progression free survival (PFS), Overall survival (OS), Incidence of participants with anti-drug antibodies (ADA) against isatuximab, Patient Expectations Questionnaire at Baseline (PEQ-BL v2) with isatuximab administered subcutaneously, Patient experience and satisfaction questionnaires (PESQ v2) with isatuximab administered subcutaneously, Health state utility assessed using Health Resource Utilization and Productivity Questionnaire (HRUPQ), Health Related Quality of Life (HRQL), European Quality of Life Group questionnaire with 5 dimensions and 5 levels per dimension (EQ-5D-5L)

Source: https://euclinicaltrials.eu/ctis-public/view/2023-508870-27-00